EU clinical trial 2025-520459-10-00: Drug-Drug Interaction between Empagliflozin 25 mg Film-Coated Tablets and Alogliptin 25 mg Film-Coated Tablets in Healthy Participants Under Fasting Conditions
Protocol code: BLCL-AE-EU-01
Sponsor: Tecnimede-Sociedade Tecnico-Medicinal S.A. (Pharmaceutical company). Phase: Human Pharmacology (Phase I)- Other. Countries: Portugal (ended).
Therapeutic area(s): Not possible to specify
Gender: Female, Male. Age: 18-64 years. Enrolment: 72.
Status: Ended. Start date (EU): 2025-02-18. End date (EU): 2025-04-01. Decision date: 2025-02-17. Results received: No. Last updated: 2025-02-17.

Condition(s): No medical condition.

Source: https://euclinicaltrials.eu/ctis-public/view/2025-520459-10-00